EU clinical trial 2024-510759-37-00: Immunological and functional characteristics of T memory-like cells in psoriasis under treatment with deucravacitinib - IM011-1115
Protocol code: IM011-1115
Sponsor: Charite Universitaetsmedizin Berlin KöR (Hospital/Clinic/Other health care facility). Phase: Therapeutic use (Phase IV). Countries: Germany (ended).
Therapeutic area(s): Diseases [C] - Skin and Connective Tissue Diseases [C17]; Diseases [C] - Immune System Diseases [C20]
Gender: Female, Male. Age: 18-64 years, 65+ years. Enrolment: 15.
Status: Ended. End date (EU): 2025-05-05. Decision date: 2024-09-06. Results received: Yes. Last updated: 2025-02-10.

Condition(s): Plaque Psoriasis
Product: SOTYKTU 6 mg film-coated tablets, SOTYKTU 6 mg film-coated tablets, SOTYKTU 6 mg film-coated tablets, SOTYKTU 6 mg film-coated tablets, SOTYKTU 6 mg film-coated tablets, SOTYKTU 6 mg film-coated tablets, SOTYKTU 6 mg film-coated tablets, SOTYKTU 6 mg film-coated tablets

Primary endpoint: This is an explorative study which aims to analyze the impact of TYK-2i on TRM-like cells. To specifically evaluate the impact of TYK-2 inhibition with deucravacitinib on TRM-like CD4+-IL17A producing T cells, both quantitatively and in terms of functional activity, after 24 weeks of treatment.
Endpoint(s): To assess the correlation between the reduction in inflammatory infiltrating cells and cytokines (specifically IL-17/IL-22/IL-23) following TYK-2 inhibition with deucravacitinib and the potential impact on TRM-like cell dynamics. This

Source: https://euclinicaltrials.eu/ctis-public/view/2024-510759-37-00